EU clinical trial 2024-514431-18-00: A research study on the effects of NNC0537-1482 in healthy individuals when injected under the skin.
Protocol code: NN6537-7650
Sponsor: Novo Nordisk A/S (Pharmaceutical company). Phase: Human Pharmacology (Phase I)- First administration to humans. Countries: Netherlands (ended).
Therapeutic area(s): Diseases [C] - Cardiovascular Diseases [C14]
Gender: Female, Male. Age: 18-64 years. Enrolment: 56.
Status: Ended. Start date (EU): 2024-10-01. End date (EU): 2025-05-04. Decision date: 2024-09-30. Results received: No. Last updated: 2024-10-15.

Condition(s): Heart Failure

Source: https://euclinicaltrials.eu/ctis-public/view/2024-514431-18-00